EU clinical trial 2023-505695-30-00: A Multicenter, Randomized, Double-Blind, Placebo-Controlled, Phase 3 Study to Evaluate the Efficacy and Safety of Litifilimab (BIIB059) in Adult Participants With Active Systemic Lupus Erythematosus Receiving Background Nonbiologic Lupus Standard of Care
Protocol code: 230LE303
Sponsor: Biogen Idec Research Limited (Pharmaceutical company). Phase: Therapeutic confirmatory (Phase III). Countries: France (ended), Sweden (ended), Bulgaria (ongoing, recruitment ended), Poland (ongoing, recruitment ended), Greece (ended), Spain (ongoing, recruitment ended).
Therapeutic area(s): Diseases [C] - Immune System Diseases [C20]
Gender: Female, Male. Age: 18-64 years, 65+ years. Enrolment: 170.
Start date (EU): 2021-11-30. Decision date: 2024-04-02. Results received: No. Last updated: 2026-05-21.
Decision dates by country: FR: 2024-04-03, SE: 2024-04-02, GR: 2024-05-20, PL: 2024-04-04, ES: 2024-04-02, BG: 2024-04-08

Condition(s): systemic lupus erythematosus
Product: BIIB059, BIIB059 placebo is a sterile liquid for injection. The formulation composition of the placebo is identical to that of BIIB059 drug product minus the active ingredient

Primary endpoint: Percentage of Participants Who Achieved a Systemic Lupus Erythematosus Responder Index of 4 (SRI-4) Response at Week 52.
Endpoint(s): Percentage of Participants Who Achieved a BICLA Response at Week 52, Percentage of Participants With at Least 4 Joints (Both Swollen and Tender) at Baseline Who Achieved a Joint-50 Response at Week 52, Percentage of Participants with OCS ≥10 milligrams per day (mg/day) at Baseline with OCS Reduction to ≤7.5 mg/day at Week 40, Which Is Sustained Through Week 52 with No Disease Worsening from Week 40 to Week 52, Percentage of Participants with a CLASI-A score ≥10 at Baseline Who Achieved a 50% Improvement From Baseline in Cutaneous Lupus Erythematosus Disease Area and Severity Index Activity Score (CLASI50) Response at Week 24, Annualized Flare Rate Through Week 52, Change from Baseline in Physician's Global Assessment (PGA) Visual Analog Scale (VAS) Score by Visit, Percentage of Participants Who Achieved a British Isles Lupus Activity Group (BILAG)-Based Combined Lupus Assessment (BICLA) Response by Visit, Time to Onset of SRI-4 Response Sustained Through Week 52, Percentage of Participants Who Achieved SRI-4, -5, or -6 Response by Visit, Percentage of Participants with Joint-50 Response by Visit, Percentage of Participants with Baseline CLASI-A Score ≥10 Who Achieved a CLASI-20, -50, -70, or -90 Response by Visit, Percentage of Participants with Baseline CLASI-A Score ≥10 Who Achieved a CLASI-A Score of ≤ 1 by Visit, Time to First British Isles Lupus Activity Group-2004 (BILAG-2004) Severe Flare by Visit, Time to First Severe Flare as defined by the Safety of Estrogens in Systemic Lupus Erythematosus National Assessment - Systemic Lupus Erythematosus Disease Activity Index Flare Index (SFI), Percentage of time spent in LLDAS., Proportion of participants with sustained LLDAS as defined by the number of participants with ≥ 3, ≥ 5, and ≥ 7 consecutive visits in LLDAS up to and including Week 52., Proportion of participants who achieved LLDAS at Week 52., Percentage of Participants With Baseline OCS ≥10 mg/day Who Achieved ≤7.5 mg/day at Week 52, Change from Baseline in Lupus-Specific Health-Related Quality-ofLife Questionnaire (LupusQoL) Score, Change From Baseline in Short Form Health Survey-36 (SF-36) Score, Change From Baseline in Functional Assessment of Chronic Illness Therapy-Fatigue (FACIT-Fatigue) Score, Change From Baseline in Patient Health Questionnaire-9 (PHQ-9) Score, Change From Baseline in Work Productivity and Activity Impairment (WPAI): Lupus Score, Number of Participants with Treatment-Emergent Adverse Events (TEAEs) and Serious Adverse Events (SAEs), Number of Participants with Antibodies to litifilimab, Percentage of Participants with severe flares through Week 52, Proportion of participants who achieved SLEDAI-2K improvement at Week 52., Proportion of participants who achieved no worsening of BILAG at Week 52., Proportion of participants who achieved no worsening of PGA-VAS at Week 52., Proportion of participants who achieved no worsening of SLEDAI-2K at Week 52., Proportion of participants who achieved BILAG improvement at Week 52., Proportion of participants with OCS ≥ 10 mg/day at Baseline with OCS reduction to ≤ 5 mg/day at Week 40, which is sustained through Week 52 with no disease worsening5 from Week 40 to Week 52., Proportion of participants with OCS ≥ 7.5 mg/day at Baseline with OCS reduction to ≤ 7.5 mg/day at Week 52.

Source: https://euclinicaltrials.eu/ctis-public/view/2023-505695-30-00